EU clinical trial 2024-511896-13-00: Use of MULTIplex PCR, procalcitonin and the appearance of sputum to reduce the duration of antibiotic therapy during severe COPD EXAcerbation: a trial controlled, randomized, open, in parallel groups, multicenter (MULTI-EXA)
Protocol code: APHP210085
Sponsor: Assistance Publique Hopitaux De Paris (Hospital/Clinic/Other health care facility). Phase: Phase III and phase IV (Integrated). Countries: France (ongoing, recruiting).
Therapeutic area(s): Diseases [C] - Respiratory Tract Diseases [C08]
Gender: Female, Male. Age: 18-64 years, 65+ years. Enrolment: 204.
Status: Ongoing, recruiting. Start date (EU): 2022-12-09. Decision date: 2024-10-31. Results received: No. Last updated: 2026-03-20.
Decision dates by country: FR: 2025-01-22

Condition(s): EA-COPD (with mechanical ventilation, invasive or non-invasive, or high-flow nasal oxygen therapy).
Product: AMOXICILLIN AND BETA-LACTAMASE INHIBITOR, CEFEPIME, CEFOTAXIME, SPIRAMYCIN, PIPERACILLIN AND BETA-LACTAMASE INHIBITOR

Primary endpoint: Number of days alive without antibiotics on D28.
Endpoint(s): Number of days with antibiotics in patients alive on D28, Number of days with broad-spectrum antibiotics in patients alive on D28, Incidence rate of nosocomial pneumonia on day 28;, Incidence rate of colonization/infection with multi-resistant bacteria on day 28;, Duration of stay in ICU/ICU at D28,, Length of hospital stay on D28;, Number of days alive without mechanical ventilation on D28, - Incidence rate of hospital-acquired pneumonia (including ventilator-acquired pneumonia) on day 28;, Mortality in ICU/ICU and in hospital (on day 28 and day 90);, - Number of additional EA-COPD(s) (requiring hospitalization and/or initiation of systemic corticosteroid therapy and/or antibiotic therapy) after the index EA-COPD (at D90);, Time between the index EA-COPD and the next EA-COPD (EA-COPD requiring hospitalization and/or initiation of systemic corticosteroid therapy and/or antibiotic therapy) (at D90);, CAT questionnaire (COPD Assessment Test) (at D90).

Source: https://euclinicaltrials.eu/ctis-public/view/2024-511896-13-00